EU clinical trial 2024-512771-12-00: An open label, balanced, randomized, two-treatment, two-period, two-sequence, single-dose, crossover, bioequivalence study comparing Upadacitinib Prolonged Release Tablets 15 mg, manufactured by Sun Pharmaceutical Industries Limited, India with RINVOQ 15 mg prolonged-release tablets (Upadacitinib), Marketing Authorization Holder: AbbVie Deutschland GmbH & Co. KG Knollstraße 67061 Ludwigshafen Germany, in healthy adult, human subjects under fed condition.
Protocol code: UPADA-02-24
Sponsor: Sun Pharmaceutical Industries Limited (Pharmaceutical company). Phase: Human Pharmacology (Phase I)- Bioequivalence Study. Countries: Romania (ended).
Therapeutic area(s): Diseases [C] - Immune System Diseases [C20]
Gender: Female, Male. Age: 18-64 years. Enrolment: 32.
Status: Ended. Start date (EU): 2024-09-17. End date (EU): 2024-11-04. Decision date: 2024-07-15. Results received: No. Last updated: 2024-07-15.

Condition(s): Axial spondyloarthritis, Crohn’s disease, Ulcerative colitis, Atopic dermatitis, Rheumatoid arthritis, Psoriatic arthritis

Source: https://euclinicaltrials.eu/ctis-public/view/2024-512771-12-00